EU clinical trial 2024-519082-22-00: Influence Of Zoledronic Acid On Healing After Arthroskopic Repair Of Chronic Rotator Cuff Lesions A Prospective, Randomized, Placebo-Controlled Phase II Trial ZORRO
Protocol code: ZORRO
Sponsor: AUVA Trauma Center Vienna (Hospital/Clinic/Other health care facility). Phase: Therapeutic exploratory (Phase II). Countries: Austria (ongoing, recruiting).
Therapeutic area(s): Diseases [C] - Musculoskeletal Diseases [C05]
Gender: Female, Male. Age: 18-64 years, 65+ years. Enrolment: 80.
Status: Ongoing, recruiting. Start date (EU): 2025-01-15. Decision date: 2025-01-14. Results received: No. Last updated: 2025-01-14.

Condition(s): Trauma (rupture of a tendon), Osteoporosis
Product: ELECTROLYTES, ZOLEDRONIC ACID

Primary endpoint: • Tendon integrity 6 months postoperative (no re-rupture/re-rupture) • Tendon integrity 12, 24 and 60 months postoperative (no re-rupture/re-rupture)
Endpoint(s): Fatty muscle infiltration, shoulder abduction and adduction, shoulder anteversion and retroversion, shoulder rotation internal and external, shoulder strength, pain evaluation, Constant-Murley-Score, American Shoulder and Elbow Surgeons Score, Subjective Shoulder Value

Source: https://euclinicaltrials.eu/ctis-public/view/2024-519082-22-00